EU clinical trial 2024-515390-99-00: A study on the effects of a new drug on the sensitivity of the nerves in healthy volunteers
Protocol code: QRL-101-05
Sponsor: Quralis Corp. (Pharmaceutical company). Phase: Human Pharmacology (Phase I)- Other. Countries: Netherlands (ended).
Therapeutic area(s): Diseases [C] - Nervous System Diseases [C10]
Gender: Female, Male. Age: 18-64 years. Enrolment: 24.
Status: Ended. Start date (EU): 2024-09-06. End date (EU): 2024-12-24. Decision date: 2024-09-05. Results received: No. Last updated: 2024-11-01.

Condition(s): Hyperexcitability nerve disorder

Source: https://euclinicaltrials.eu/ctis-public/view/2024-515390-99-00